EU clinical trial 2024-514886-21-00: Comparison of a personalized maintenance therapy based on the evolution of anti-desmoglein antibodies as biomarkers of pemphigus subclinical activity, with the standard treatment (rituximab + corticosteroids) in pemphigus - (RITUX 4)
Protocol code: 2020/0424/HP
Sponsor: Centre Hospitalier Universitaire Rouen (Hospital/Clinic/Other health care facility). Phase: Therapeutic use (Phase IV). Countries: France (ongoing, recruiting).
Therapeutic area(s): Diseases [C] - Skin and Connective Tissue Diseases [C17]
Gender: Female, Male. Age: 18-64 years, 65+ years. Enrolment: 133.
Status: Ongoing, recruiting. Start date (EU): 2024-11-06. Decision date: 2024-08-22. Results received: No. Last updated: 2026-01-23.

Condition(s): Pemphigus diseases (Pemphigus Vulgaris - PV and Pemphigus Foliaceus (PF).
Product: MabThera 500 mg concentrate for solution for infusion

Primary endpoint: Any concomitant condition that required treatment with oral or systemic corticosteroids within 12 weeks prior to randomization- excluding transitory treatments (such as a corticosteroid therapy prescribed for a few days for an acute infection), and chronic corticosteroid treatments with a prednisone / prednisolone dose ≤20 mg/day, (these latter patients remain eligible for study entry)

Source: https://euclinicaltrials.eu/ctis-public/view/2024-514886-21-00